EU clinical trial 2025-522915-40-00: A phase 1, Pharmacokinetic Comparison of Vonafexor Acid and Its Lysine Salt (EYP651) and Evaluation of Potential Drug-Drug Interactions.
Protocol code: EYP001-110/OP1147
Sponsor: ENYO Pharma (Pharmaceutical company). Phase: Human Pharmacology (Phase I)- Other. Countries: France (ongoing, recruiting).
Therapeutic area(s): Diseases [C] - Digestive System Diseases [C06]; Diseases [C] - Nutritional and Metabolic Diseases [C18]
Gender: Female, Male. Age: 18-64 years. Enrolment: 40.
Status: Ongoing, recruiting. Start date (EU): 2025-10-28. Decision date: 2025-10-09. Results received: No. Last updated: 2025-10-09.

Condition(s): Healthy volunteers, Impaired renal function and suspected MASH

Source: https://euclinicaltrials.eu/ctis-public/view/2025-522915-40-00